EU clinical trial 2022-502880-39-00: A Global, Open-label, Adaptive Design Study to Investigate the Efficacy and Safety of SerpinPC in Subjects With Severe Hemophilia A or Moderately Severe to Severe Hemophilia B (PRESent-2)
Protocol code: AP-0102
Sponsor: Apcintex Limited (Pharmaceutical company). Phase: Therapeutic exploratory (Phase II). Countries: Spain (ended), Germany (ended), Belgium (ended), Italy (ended), France (ended), Poland (ended), Bulgaria (ended).
Therapeutic area(s): Diseases [C] - Hemic and Lymphatic Diseases [C15]
Gender: Male. Age: 0-17 years, 18-64 years. Enrolment: 59.
Status: Ended. Start date (EU): 2023-11-13. End date (EU): 2025-01-16. End date: 2025-02-28. Decision date: 2023-07-25. Results received: Yes. Last updated: 2024-10-21.
Decision dates by country: PL: 2023-07-31, BE: 2023-07-26, ES: 2023-07-25, FR: 2023-07-31, DE: 2023-07-26, IT: 2023-07-26, BG: 2024-10-21

Condition(s): Severe Hemophilia A or Moderately Severe to Severe Hemophilia B
Product: SerpinPC

Primary endpoint: Study Endpoint: Treated bleeds (expressed as annualized bleeding rate [ABR]) in the observation period and under SerpinPC at the end of Part 2 Week 24 in subjects with HemB previously receiving “on-demand” treatment
Endpoint(s): Treated bleeds (expressed as ABR) other than those defined by the primary endpoint (eg, bleeds during the first 48 weeks, and in those subjects receiving prior “prophylaxis” treatment), Treated spontaneous bleeds (expressed as ABR), Treated spontaneous joint bleeds (expressed as ABR), All bleeds requiring treatment (expressed as ABR, ie, all treated bleeds and all bleeds that would ordinarily be treated with factor concentrate/bypass agent if therapy were available), Total coagulation factor and/or bypass product consumption, PK concentrations of SerpinPC throughout the study, Haemophilia-specific QoL Instrument for Adults (Haem-A-QoL) Physical Health scale in subjects aged 17 to ≤65 years with hemophilia and the end of Part 3 Week 24).

Source: https://euclinicaltrials.eu/ctis-public/view/2022-502880-39-00